EU clinical trial 2024-516699-14-00: A Phase I/IIa, Open-label, Multi-centre Study to Assess the Safety, Tolerability, Pharmacokinetics, and Preliminary Efficacy of AZD0022 Monotherapy and in Combination with Anti-cancer Agents in Participants with Tumours Harbouring a KRASG12D Mutation (ALAFOSS-01)
Protocol code: D7080C00001
Sponsor: AstraZeneca AB (Pharmaceutical company). Phase: Phase I and Phase II (Integrated)- First administration to humans. Countries: Belgium (ended), Poland (ended), Italy (ended), Netherlands (ended), Spain (ended).
Therapeutic area(s): Diseases [C] - Neoplasms [C04]
Gender: Female, Male. Age: 18-64 years, 65+ years. Enrolment: 126.
Status: Ended. Start date (EU): 2025-04-23. End date (EU): 2025-10-09. End date: 2026-01-29. Decision date: 2025-03-13. Results received: No. Last updated: 2025-08-22.
Decision dates by country: BE: 2025-03-13, IT: 2025-03-19, ES: 2025-03-13, NL: 2025-03-24, PL: 2025-03-24

Condition(s): Non Small Cell Lung Cancer; Colorectal Cancer; Pancreatic Ductal Adenocarcinoma
Product: AZD0022, AZD0022, Erbitux 5 mg/mL solution for infusion

Primary endpoint: For Parts A & B: • Incidence and severity of AEs/SAEs • Incidence of DLTs (Dose Escalation) • Clinically significant changes in vital signs, laboratory parameters, and ECG results • Discontinuation of AZD0022 due to toxicity For Part C: • ORR evaluated according to RECIST v1.1
Endpoint(s): For Parts A&B: • Radiological response evaluated according to RECIST v1.1 (ORR, CR rate, DoR, DCR, DRR, TTR, PFS, and change in tumour size). • OS, Continuation of Parts A&B as some translations total more than 500 characters. The proportion of participants demonstrating a complete molecular response upon treatment • Determine plasma, urine, and whole blood concentrations and where appropriate determine PK parameters including, but not limited to Cmax, tmax, AUClast, and t1/2λz after oral administration of AZD0022 and amount excreted in urine., For Part C: • Incidence of AEs/SAEs • Clinically significant changes in vital signs, laboratory parameters, and ECG results • AZD0022 discontinuation due to toxicity • Radiological response evaluated according to RECIST v1.1 (CR rate, DoR, DCR, DRR, TTR, PFS, and change in tumour size), Continuation of Part C as some translation total more than 500 characters • OS • The proportion of participants demonstrating a complete molecular response upon treatment • TDT • TFST

Source: https://euclinicaltrials.eu/ctis-public/view/2024-516699-14-00